EU clinical trial 2024-514818-12-00: TailorDose®-II: Therapeutic dose monitoring of commonly used cytostatic drugs/regimes indicated for breast cancer
Protocol code: TailorDose-II
Sponsor: Karolinska Institutet (Educational Institution). Phase: Therapeutic use (Phase IV). Countries: Sweden (authorised, recruitment pending).
Therapeutic area(s): Diseases [C] - Neoplasms [C04]
Gender: Female. Age: 18-64 years, 65+ years. Enrolment: 200.
Status: Authorised, recruitment pending. Decision date: 2024-08-28. Results received: No. Last updated: 2026-04-02.

Condition(s): Breast cancer female NOS
Product: Doxorubicin Accord 2 mg/ml koncentrat till infusionsvätska, lösning, Paclitaxel Accord 6 mg/ml koncentrat till infusionsvätska, lösning, Docetaxel Ebewe 10 mg/ml koncentrat till infusionsvätska, lösning, Epirubicin Accord 2 mg/ml injektions-/infusionsvätska, lösning, Sendoxan pulver till injektionsvätska, lösning

Primary endpoint: The primary endpoint is to measure the incidence of grade 1-2 anemia (as defined by CTC v.4) in two exposure groups; high and low, in patients treated with EPI and CPA.
Endpoint(s): What correlations can be identified between exposure (AUC) and; hematologic-, liver-, cardiac- and ovarian toxicity?, What correlations can be identified between exposure (AUC) and the patients’ quality of life?, To what extent can genetic predispositions for drug metabolism be used to identify patients at increased risk of under- or overdose?, What correlations can be identified between exposure (AUC) and tumor response in patients receiving neo-adjuvant treatment?, What correlations can be identified between; BMI, age, smoking habits and renal status vs. exposure (AUC)?, Can we identify any relationship between drug exposure (AUC) and; medical care needs, level of employment and time for recovery?, Is there a difference in total and recurrence-free survival, between patients with low compared to medium or high exposure (AUC)?, Is there a difference in the prevalence of severe adverse events in patients’ with high compared to low exposure (AUC)?, Is the dose measurement in capillary blood samples equal or comparable to venous blood samples?, What correlations between exposure (AUC) and circulating extracellular vesicles can be identified?, What correlations between exposure (AUC) and health state utility values can be identified?, Is there a difference in health care costs associated with severe adverse events in patients exhibiting high exposure compared to those with low exposure (AUC)?, Capillary self-sampling success and sample quality rate., Usability and acceptability of microsampling devices based on patient feedback: Usability Questionnaire.

Source: https://euclinicaltrials.eu/ctis-public/view/2024-514818-12-00